EU clinical trial 2023-506189-29-00: A phase II, randomized, double-blind, multi-centre trial to evaluate the safety and immunogenicity of BIMERVAX® when coadministered with seasonal surface antigen, inactivated, adjuvanted influenza vaccine (SIIV) in adults older than 65 years of age fully vaccinated against COVID-19.
Protocol code: HIPRA-HH-11
Sponsor: Hipra Scientific S.L. (Pharmaceutical company). Phase: Therapeutic exploratory (Phase II). Countries: Spain (ended).
Therapeutic area(s): Diseases [C] - Virus Diseases [C02]; Diseases [C] - Respiratory Tract Diseases [C08]
Gender: Female, Male. Age: 65+ years. Enrolment: 300.
Status: Ended. Start date (EU): 2023-09-04. End date (EU): 2023-11-03. Decision date: 2023-07-14. Results received: Yes. Last updated: 2023-07-14.

Condition(s): SARS-CoV-2 and Influenza
Product: BIMERVAX emulsion for injection COVID-19 Vaccine (recombinant, adjuvanted), Fluad Tetra, suspension for injection in pre-filled syringe Influenza vaccine (surface antigen, inactivated, adjuvanted)

Primary endpoint: Number, percentage, and characteristics of solicited local and systemic reactions through Day 7 after vaccination., Number, percentage, and characteristics of unsolicited local and systemic adverse events (AEs) through the end of the study., Number and percentage of serious adverse events (SAEs) through the end of the study., Number and percentage of adverse events of special interest (AESI) through the end of the study.
Endpoint(s): Binding antibodies titre measured for each individual sample and GMT for treatment group comparison at Baseline and at Day 28 elicited by BIMERVAX® when coadministered with SIIV or administered alone., Geometric mean fold rise (GMFR) in binding antibodies titre from Baseline and Day 28 elicited by BIMERVAX® when coadministered with SIIV or administered alone., Strain specific HAI antibody titers (expressed as GMT) at Baseline and at Day 28, elicited by SIIV when coadministered with BIMERVAX®, or administered alone., Geometric mean fold rise (GMFR) in strain specific HAI titers elicited at Day 28 by SIIV when coadministered with BIMERVAX® or administered alone.

Source: https://euclinicaltrials.eu/ctis-public/view/2023-506189-29-00